EU clinical trial 2023-507028-22-00: The impact of ovarian stimulation intensity on embryo euploidy in advanced age women. A randomized controlled trial
Protocol code: FSD-INO-2023-14
Sponsor: Santiago Dexeus Font Fundacio Privada (Laboratory/Research/Testing facility). Phase: Therapeutic use (Phase IV). Countries: Spain (ongoing, recruiting).
Therapeutic area(s): Diseases [C] - Female Urogenital Diseases and Pregnancy Complications [C13]
Gender: Female. Age: 18-64 years. Enrolment: 110.
Status: Ongoing, recruiting. Start date (EU): 2023-12-12. Decision date: 2023-11-14. Results received: No. Last updated: 2024-07-04.

Condition(s): Infertility
Product: Decapeptyl diario 0,1 mg polvo y disolvente para solución inyectable, REKOVELLE 72 micrograms/2.16 mL solution for injection in a pre-filled pen, Seidigestan 200 mg cápsulas blandas

Primary endpoint: To compare the two stimulation groups of 15 vs 20 mcg of follitropin-delta (equivalent to 225IU vs 300IU of rFSH) regarding the number of euploid embryos in advanced age women undergoing PGT-A with a PPOS protocol
Endpoint(s): Total gonadotropin dose and length of stimulation, Number of oocytes and mature oocytes (MIIs) retrieved, Endocrine profile at specific intervals (estradiol, progesterone, FSH and LH), Follicle to Oocyte Index (FOI) (ratio between the total number of oocytes collected at the end of ovarian stimulation and the number of antral follicles available at the start of stimulation)., Follicular Output RaTe (FORT) (ratio of the number of preovulatory follicles and the number of antral follicles available at the start of stimulation)., Cycle cancelation rate, Reason for cycle cancelation, Fertilization rate, Time of appearance of the 2nd polar body (tPB2), Time of pronuclei appearance (tPNa), Evaluation of both pronuclei (PN), Time of pronuclei disappearance (tPNf), Time of division from 2 to 8 cells (t2, t3, t4, t5, t6, t7, t8), Time of compactation (tSC), Time of morula (tM), Time of cavitation (tSB), Time of full blastulation (tB), Total number of day 5 blastocysts, Total number of good quality blastocysts, Total number of embryos, Blastocyst formation rate, defined as the proportion of 2PN zygotes that reach the blastocyst stage, Number of embryos cryopreserved, Embryo stage (D5, D6, D7), Clinical pregnancy rate, defined as the visualization of one or more gestational sacs, Ongoing pregnancy rate, defined as a viable intrauterine pregnancy of at least 8-10 weeks duration confirmed on an ultrasound scan

Source: https://euclinicaltrials.eu/ctis-public/view/2023-507028-22-00